EU clinical trial 2024-513349-35-00: A Phase 3 Study to Evaluate the Safety and Efficacy of a Single Dose of CTX001 in Pediatric Subjects With Transfusion-Dependent β-Thalassemia
Protocol code: VX21-CTX001-141
Sponsor: Vertex Pharmaceuticals Inc. (Pharmaceutical company). Phase: Therapeutic confirmatory (Phase III). Countries: Germany (ongoing, recruiting), Italy (ongoing, recruiting).
Therapeutic area(s): Diseases [C] - Congenital, Hereditary, and Neonatal Diseases and Abnormalities [C16]
Gender: Female, Male. Age: 0-17 years. Enrolment: 4.
Status: Ongoing, recruiting. Start date (EU): 2022-05-16. Decision date: 2024-11-25. Results received: No. Last updated: 2026-06-11.
Decision dates by country: IT: 2025-01-14, DE: 2024-11-25

Condition(s): Transfusion-Dependent-Thalassemia
Product: FILGRASTIM, PLERIXAFOR, Casgevy 4 - 13 x 10^6 cells/mL dispersion for infusion, BUSULFAN

Primary endpoint: Proportion of subjects who achieve TI12. A subject will be considered to have achieved TI12 if he/she has maintained weighted average Hb ≥9 g/dL without RBC transfusions for at least 12 consecutive months any time after CTX001 infusion. The evaluation of TI12 starts 60 days after last RBC transfusion for post-transplant support or TDT disease management.
Endpoint(s): Proportion of Participants Achieving at Least 95 Percent (%), 90%, 85%, 75% and 50% Reduction in Annualized Transfusions, Relative Reduction in Annualized Volume and episodes of RBC Transfusions, Transfusion Free Duration for Participants who Achieve TI12, Proportion of Alleles With Intended Genetic Modification Present in Peripheral Blood Over Time, Proportion of Alleles With Intended Genetic Modification Present in CD34+ Cells of the Bone Marrow Over Time, HbF concentration (pre-transfusion) over time, Total hemoglobin concentration (pre-transfusion) over time., Safety and tolerability of CTX001 based on adverse events (AEs), clinical laboratory values, vital signs, neutrophil engraftment, platelet engraftment, transplant-related mortality (TRM), and all-cause mortality, Proportion of subjects who achieve TI6. A subject will be considered to have achieved TI6 if he/she has maintained weighted average Hb ≥9 g/dL without RBC transfusions for at least 6 consecutive months any time after CTX001 infusion. The evaluation of TI6 starts 60 days after last RBC transfusion for post-transplant support or TDT disease management.

Source: https://euclinicaltrials.eu/ctis-public/view/2024-513349-35-00